EU clinical trial 2024-514885-38-00: Randomized double blind double dummy control trial comparing the safety and efficacy of rituximab versus oral cyclophosphamide in severe forms of mucous membrane pemphigoid - (RITUX-MMP)
Protocol code: 2015/208/HP
Sponsor: Centre Hospitalier Universitaire Rouen (Hospital/Clinic/Other health care facility). Phase: Therapeutic confirmatory (Phase III). Countries: France (ongoing, recruitment ended).
Therapeutic area(s): Diseases [C] - Skin and Connective Tissue Diseases [C17]
Gender: Female, Male. Age: 18-64 years, 65+ years. Enrolment: 130.
Status: Ongoing, recruitment ended. Start date (EU): 2019-07-11. Decision date: 2024-10-16. Results received: No. Last updated: 2026-07-29.

Condition(s): severe forms of mucous membrane pemphigoid
Product: GLUCOSE, LACTOSE, ENDOXAN 50 mg, comprimé enrobé, MabThera 500 mg concentrate for solution for infusion

Primary endpoint: Proportion of patients achieving complete remission (CR) or Partial Remission (PR) at Month12, defined as "CR: absence of any inflammatory lesion, blister or erosion, and, absence of new fibrosing lesions, and/or absence of worsening of established fibrosing lesions PR: presence of transient new inflammattory lesions, blisters or erosions that heal within one week without treatment and, absence of new fibrosing lesions, and/or absence of worsening of established fibrosing lesions
Endpoint(s): • Efficacy on disease activity: - Mean evolution of MMP DAI activity score from Week 0 to Week 104 - Time to achieve CR or PR - Cumulative duration of periods of CR or PR during the study - Number of flares / relapses during the study. - Time to disease flare/relapse - Quality of life measured at baseline, M3, M6, M12, M18 and M24 by the AB QOL and TAB QOL scores, which are quality of life questionnaires specifically developed for patients with autoimmune blistering diseases., • Efficacy on prevention of post inflammatory fibrosis and scarring from resolving lesions: - Mean evolution of the MMP DAI damage score from Week 0 to Week 104 including: - Ocular involvement assessed by ophthalmologists using the MMPDAI eye subsection score. - Rate of patients developing new laryngeal, tracheal or oesophageal stenosis. - Proportion of patients with new scarring sequelae necessitating an invasive procedure from Week 0 to Week 104., • -Tolerance: - Number of Serious Adverse Event, (SAEs) including fatal, Non-Serious Adverse Event, SAEs leading to drug discontinuation/withdrawal of the patient from the study (using Common Terminology Criteria for Adverse Events (CTCAE and MeDRA terminology), - Number and causes of death during the study, • -Biological assessment -Decrease of serum antibodies directed against the different target antigens of BMZ involved in MMP (BP180, laminin 332, type 7 collagen) by ELISA assays - Affinity of corresponding auto-antibodies; - Evolution of the number of BPAG2- specific peripheral blood B lymphocytes measured by ELISPOT assay, in both treatment groups.

Source: https://euclinicaltrials.eu/ctis-public/view/2024-514885-38-00